EU clinical trial 2023-505786-88-00: A Randomized, Double-Blind, Double Dummy, Parallel Group, Multicenter 24 to 52 Week Variable Length Study to Assess the Efficacy and Safety of Budesonide, Glycopyrronium, and Formoterol Fumarate Metered Dose Inhaler (MDI) Relative to Budesonide and Formoterol Fumarate MDI and Symbicort® pMDI in Adult and Adolescent Participants with Inadequately Controlled Asthma (LOGOS)
Protocol code: D5982C00008
Sponsor: Astrazeneca AB (Pharmaceutical company). Phase: Therapeutic confirmatory (Phase III). Countries: Portugal (ended), Greece (ended), Germany (ended), Czechia (ended), Slovakia (ended).
Therapeutic area(s): Diseases [C] - Respiratory Tract Diseases [C08]
Gender: Female, Male. Age: 0-17 years, 18-64 years, 65+ years. Enrolment: 441.
Status: Ended. Start date (EU): 2021-04-25. End date (EU): 2025-03-19. End date: 2025-03-20. Decision date: 2024-03-13. Results received: Yes. Last updated: 2025-03-21.
Decision dates by country: SK: 2024-03-13, PT: 2024-03-13, CZ: 2024-03-13, GR: 2024-04-23, DE: 2024-03-15

Condition(s): Severe and inadequately controlled asthma
Product: Placebo pMDI to match budesonide/formoterol fumarate pMDI, PREDNISOLONE, Placebo MDI to match to Budesonide, Glycopyronium and Formoterol Fumarate/ Budesonide and Formoterol Fumarate MDI, SALBUTAMOL, Trixeo Aerosphere 5 micrograms/7.2 micrograms/160 micrograms pressurised inhalation, suspension, Budesonide, Glycopyronium and Formoterol Fumarate, Symbicort, 160 mikrogram/4,5 mikrogram/puff inhalationsspray, suspension

Primary endpoint: Europe (EU): Change from baseline in morning pre-dose trough FEV1 over 24 Weeks. Primary end point(s) of Pooled Studies D5982C00007 and D5982C00008. 1. Rate of severe asthma exacerbations.
Endpoint(s): Onset of action on Day 1: Absolute change in FEV1 at 5 minutes on Day 1., Change from baseline in FEV1 AUC0-3 over 24 Weeks, Percentage of responders in ACQ-7 (≥0.5 decrease equals response) over 24 weeks., Percentage of responders in ACQ-5 (≥0.5 decrease equals response) over 24 weeks., Percentage of responders in the Asthma Quality of Life Questionnaire for 12 years and older (AQLQ(s)+12) (≥0.5 increase equals response) over 24 weeks., Percentage of responders in the St. George's Respiratory Questionnaire (SGRQ) (≥4.0 unit decrease equals response) at Week 24., Rate of severe asthma exacerbations over the Treatment Period, Secondary end point of Pooled Studies D5982C00007 and D5982C00008: Time to first severe asthma exacerbation., Secondary end point of Pooled Studies D5982C00007 and D5982C00008: Rate of moderate/severe asthma exacerbations., Secondary end point of Pooled Studies D5982C00007 and D5982C00008: Time to first moderate/severe asthma exacerbation., Secondary end point of Pooled Studies D5982C00007 and D5982C00008: Rate of severe asthma exacerbations for participants with percent predicted FEV1 ≤ 55% at baseline., Secondary end point of Pooled Studies D5982C00007 and D5982C00008: Rate of severe asthma exacerbations for participants with ≥ 1 severe exacerbation in the 12 months prior to Visit 1.

Source: https://euclinicaltrials.eu/ctis-public/view/2023-505786-88-00